EU clinical trial 2022-501876-24-00: Study Evaluating the Safety, Efficacy, and Pharmacokinetics of Mosunetuzumab and a Combined Regimen of Mosunetuzumab and Venetoclax in Patients with Relapsed or Refractory Chronic Lymphocytic Leukemia
Protocol code: BO43243
Sponsor: F. Hoffmann-La Roche AG (Pharmaceutical company). Phase: Human Pharmacology (Phase I)- Other. Countries: Italy (ongoing, recruiting), Spain (ongoing, recruiting), Germany (ongoing, recruiting), France (ended), Poland (ongoing, recruiting).
Therapeutic area(s): Diseases [C] - Neoplasms [C04]
Gender: Female, Male. Age: 18-64 years, 65+ years. Enrolment: 54.
Start date (EU): 2022-06-17. Decision date: 2023-04-11. Results received: No. Last updated: 2026-08-03.
Decision dates by country: FR: 2023-04-27, IT: 2023-04-21, DE: 2023-04-24, PL: 2025-08-18, ES: 2023-04-11

Condition(s): Relapsed or Refractory (R/R) Chronic Lymphocytic Leukemia (CLL)

Source: https://euclinicaltrials.eu/ctis-public/view/2022-501876-24-00